EU clinical trial 2025-524686-24-00: C6461014 - A Phase 2 Interventional Study of PF-08634404 in Combination with Chemotherapy in Participants with Previously Untreated Transformed Small Cell Lung Cancer
Protocol code: C6461014
Sponsor: Pfizer Inc. (Pharmaceutical company). Phase: Therapeutic exploratory (Phase II). Countries: France (authorised, recruitment pending), Italy (authorised, recruitment pending), Spain (authorised, recruitment pending).
Therapeutic area(s): Diseases [C] - Neoplasms [C04]
Gender: Female, Male. Age: 18-64 years, 65+ years. Enrolment: 15.
Status: Authorised, recruitment pending. Decision date: 2026-06-29. Results received: No. Last updated: 2026-07-06.
Decision dates by country: FR: 2026-06-29, IT: 2026-07-02, ES: 2026-07-06

Condition(s): Small Cell Lung Cancer
Product: CARBOPLATIN, ETOPOSIDE, PF-08634404

Primary endpoint: Confirmed ORR as assessed by investigator based on RECIST v1.1, AEs as characterized by type, frequency, severity (as graded by NCI CTCAE version 5.0), timing, seriousness, and relationship to study intervention.
Endpoint(s): DOR as assessed by investigator based on RECIST v1.1, PFS as assessed by investigator based on RECIST v1.1, OS, Laboratory abnormalities as characterized by type, frequency, severity (as graded by NCI CTCAE version 5.0), and timing., Predose and postdose concentrations of PF-08634404., Incidence of ADA against PF-08634404.

Source: https://euclinicaltrials.eu/ctis-public/view/2025-524686-24-00